EU clinical trial 2024-519590-19-00: A randomized, open label, multicenter, Phase 2 study to evaluate the safety and efficacy of two dose levels of ONO-4578 with Opdivo® in combination with mFOLFOX6 and bevacizumab versus standard of care for first-line treatment of non-MSI-H/dMMR, PD-L1 positive advanced colorectal cancer.
Protocol code: ONO-4578-10
Sponsor: Ono Pharmaceutical Co. Ltd. (Pharmaceutical company). Phase: Therapeutic exploratory (Phase II). Countries: Spain (ongoing, recruiting), France (ongoing, recruiting), Italy (ongoing, recruiting).
Therapeutic area(s): Diseases [C] - Neoplasms [C04]
Gender: Female, Male. Age: 18-64 years, 65+ years. Enrolment: 76.
Status: Ongoing, recruiting. Start date (EU): 2025-11-25. Decision date: 2025-09-10. Results received: No. Last updated: 2026-02-23.
Decision dates by country: ES: 2025-09-11, IT: 2025-09-10, FR: 2025-09-12

Condition(s): PD-L1 positive advanced colorectal cancer
Product: ONO-4578, ONO-4578, BEVACIZUMAB, ONO-4578, CALCIUM FOLINATE, OXALIPLATIN, OPDIVO 10 mg/mL concentrate for solution for infusion., FLUOROURACIL

Primary endpoint: - Incidence and severity of Adverse Events (AEs) and Serious Adverse Events (SAEs) - Dose interruptions, dose reductions, and drug discontinuations due to treatment-emergent AEs, Overall response rate (ORR) by Blinded Independent Central Review (BICR) per Response Evaluation Criteria in Solid Tumors (RECIST) v1.1
Endpoint(s): - Changes in physical examination findings - Changes in laboratory parameters (hematology, clinical chemistry, coagulation, and urinalysis) - Changes in 12-lead electrocardiogram (ECG) findings, - ORR site Investigator assessment per RECIST v1.1 - Overall survival (OS) - Progression-free survival (PFS) by BICR and site Investigator assessment per RECIST v1.1 - Best overall response (BOR) by BICR and site Investigator assessment per RECIST v1.1 - Duration of response (DOR) by BICR and site Investigator assessment per RECIST v1.1, - Disease control rate (DCR) by BICR and site Investigator assessment per RECIST v1.1 - Time to response (TTR) by BICR and site Investigator assessment per RECIST v1.1 - Maximum percent change in the sum of the diameters of the target lesions by BICR and site Investigator assessment per RECIST v1.1, - Progression-free survival of second line therapy (PFS2) by site Investigator assessment per RECIST v1.1

Source: https://euclinicaltrials.eu/ctis-public/view/2024-519590-19-00